EU clinical trial 2024-513532-23-00: A randomized non-inferiority clinical trial of doxycycline vs BPG for early syphilis
Protocol code: APHP180588
Sponsor: Assistance Publique Hopitaux De Paris (Hospital/Clinic/Other health care facility). Phase: Therapeutic confirmatory (Phase III). Countries: France (ended).
Therapeutic area(s): Diseases [C] - Bacterial Infections and Mycoses [C01]
Gender: Female, Male. Age: 18-64 years, 65+ years. Enrolment: 200.
Status: Ended. Start date (EU): 2021-12-06. End date (EU): 2025-07-23. Decision date: 2024-06-28. Results received: No. Last updated: 2025-08-29.

Condition(s): early syphilis
Product: DOXYCYCLINE SANDOZ 100 mg, comprimé sécable, EXTENCILLINE 2,4 MUI, poudre et solvant pour suspension injectable IM

Primary endpoint: A response will be defined as a four-fold decrease (2 dilutions) in titer in the non-treponemal assay (VDRL or RPR) at month 6 relative to the results of the assay performed before treatment. The two assays (before treatment and at month 6) should be performed in the same laboratory
Endpoint(s): Occurrence of SAEs in the two groups, Adherence to doxycycline, evaluated on the basis of a tablet count between weeks 1 and 2, during planned visits, Occurrence of other STDs in the two groups at month 6, Titer obtained in the non-treponemal assay (VDRL or RPR) at month 3 evolution

Source: https://euclinicaltrials.eu/ctis-public/view/2024-513532-23-00